EU clinical trial 2023-506923-27-00: PIONEER TEENS Efficacy and safety of oral semaglutide versus placebo both in combination with metformin and/or basal insulin in children and adolescents with type 2 diabetes.
Protocol code: NN9924-4437
Sponsor: Novo Nordisk A/S (Pharmaceutical company). Phase: Therapeutic confirmatory (Phase III). Countries: Greece (ended), Czechia (ended), Portugal (ended), Romania (ended), Austria (ended), Netherlands (ended).
Therapeutic area(s): Diseases [C] - Nutritional and Metabolic Diseases [C18]
Gender: Female, Male. Age: 0-17 years. Enrolment: 20.
Status: Ended. Start date (EU): 2020-10-30. End date (EU): 2026-04-29. End date: 2026-04-30. Decision date: 2024-06-19. Results received: Yes. Last updated: 2025-10-27.
Decision dates by country: CZ: 2024-06-20, NL: 2024-06-19, GR: 2024-08-28, PT: 2024-07-02, RO: 2024-06-20, AT: 2024-06-24

Condition(s): Type 2 diabetes
Product: Rybelsus 7 mg tablets, Placebo (semaglutide) tablet, Rybelsus 3 mg tablets, Rybelsus 14 mg tablets

Primary endpoint: Change from baseline (week 0) to week 26 in glycosylated haemoglobin (HbA1c) (%-point and mmol/mol)
Endpoint(s): Change from baseline (week 0) to week 26 in fasting plasma glucose (FPG) (mmol/L), Change from baseline (week 0) to week 26 in body mass index (BMI) standard deviation score (SDS), Change from baseline (week 0) to week 26 and to week 52 in HbA1c (%-point and mmol/mol) (only at week 52), Change from baseline (week 0) to week 26 and to week 52 in FPG (mmol/L) (only at week 52), Change from baseline (week 0) to week 26 and to week 52 in body weight (kg), Change from baseline (week 0) to week 26 and to week 52 in body weight (relative change, %), Change from baseline (week 0) to week 26 and to week 52 in waist circumference (cm), Change from baseline (week 0) to week 26 and to week 52 in BMI SDS (only at week 52), Change from baseline (week 0) to week 26 and to week 52 in BMI percentile (age and gender adjusted) (%), Change from baseline (week 0) to week 26 and to week 52 in systolic and diastolic blood pressure (mmHg), HbA1c <7.0% (53 mmol/mol) at week 26 (yes/no), American Diabetes Association (ADA) target and International Society for Pediatric and Adolescent Diabetes (ISPAD) guidelines from 201818, HbA1c ≤6.5% (48 mmol/mol) at week 26 (yes/no), American Association of Clinical Endocrinologists (AACE) target, HbA1c <7.0% (53 mmol/mol) at week 52 (yes/no), ADA target and ISPAD guidelines from 201818, HbA1c ≤6.5% (48 mmol/mol) at week 52 (yes/no), AACE target, Time to additional anti-diabetic medication (to support the treatment policy estimand), Time to rescue medication (to support the hypothetical estimand), Number of treatment-emergent adverse events (TEAEs) during exposure to trial product, assessed up to approximately 57 weeks, Number of treatment-emergent severe or blood glucose confirmed symptomatic hypoglycaemic episodes from randomisation to week 26, Number of treatment-emergent severe or blood glucose confirmed symptomatic hypoglycaemic episodes during exposure to trial product, assessed up to approximately 57 weeks, Treatment-emergent severe or blood glucose confirmed symptomatic hypoglycaemia episode from randomisation to week 26 (yes/no), Treatment-emergent severe or blood glucose confirmed symptomatic hypoglycaemia episode during exposure to trial product, assessed up to approximately 57 weeks (yes/no), Change from baseline (week 0) to week 26 and week 52 in biochemistry, Change from baseline (week 0) to week 26 and week 52 in amylase (U/L), Change from baseline (week 0) to week 26 and week 52 in lipase (U/L), Change from baseline (week 0) to week 26 and week 52 in biomarkers, Change from baseline (week 0) to week 26 and week 52 in insulin-like growth factor 1 (IGF-1) (ng/mL), Change from baseline (week 0) to week 26 and week 52 in insulin–like growth factor binding protein 3 (IGFBP 3) (ng/mL), Change from baseline (week 0) to week 26 and week 52 in hormones, Change from baseline (week 0) to week 26 and week 52 in calcitonin (pmol/L), Change from baseline (week 0) to week 26 and week 52 in estradiol (for girls) (pmol/L), Change from baseline (week 0) to week 26 and week 52 in testosterone (for boys) (nmol/L), Change from baseline (week 0) to week 26 and week 52 in prolactin (mIU/L), Change from baseline (week 0) to week 26 and week 52 in thyroid stimulating hormone (TSH/thyrotropin) (mIU/L), Change from baseline (week 0) to week 26 and week 52 in follicle stimulating hormone (FSH) (mIU/mL), Change from baseline (week 0) to week 26 and week 52 in luteinizing hormone (LH) (mIU/mL), Change from baseline (week 0) to week 26 and week 52 in dehydroepiandrosterone sulfate (DHEAS) (μmol/L), Anti-semaglutide antibodies endpoints during 57 weeks - anti-semaglutide antibody status., Anti-semaglutide antibodies endpoints during 57 weeks - Anti-semaglutide antibody titer., Anti-semaglutide antibodies endpoints during 57 weeks - Anti-semaglutide antibodies with in vitro neutralising effect to semaglutide, Anti-semaglutide antibodies endpoints during 57 weeks - Anti-semaglutide antibodies cross reacting with endogenous GLP-1, Anti-semaglutide antibodies endpoints during 57 weeks - Cross reacting antibodies with in vitro neutralising effect to endogenous GLP-1, The following will be assessed at week 26 and week 52 - Height velocity (cm/year), The safety assessments are change from baseline (week 0) to week 26 and week 52 in - Height SDS, The safety assessments are change from baseline (week 0) to week 26 and week 52 in - Bone age assessment, X-ray (only at week 52) (years), The safety assessments are change from baseline (week 0) to week 26 and week 52 in - Pubertal assessment (Tanner staging) (stage 1-5 where 5 is full sexual maturity), The safety assessments are change from baseline (week 0) to week 26 and week 52 in - Pulse rate (beats/minute), Change from pre-dose to post-dose (25 and 40 min) at week 12 and week 26 in Lactate (mmol/L), Pharmacokinetic (PK) sampling of semaglutide from eight visits over the treatment period of 52 weeks with three samples performed during the dose escalation period will be included in an analysis comparing the following PK properties to historical adult data, at steady state - Apparent clearance (CL/F) (L/h), Pharmacokinetic (PK) sampling of semaglutide from eight visits over the treatment period of 52 weeks with three samples performed during the dose escalation period will be included in an analysis comparing the following PK properties to historical adult data, at steady state -Average concentration (Cavg) (nmol/L), SNAC PK samples collected in this trial will be evaluated using relevant summary statistics and compared to historical adult data - SNAC plasma concentrations (ng/mL)

Source: https://euclinicaltrials.eu/ctis-public/view/2023-506923-27-00